EU clinical trial 2022-500271-31-00: A Phase I Clinical Trial to Evaluate the Safety, Tolerability, and Pharmacokinetics of single ascending doses of 4P-004 versus placebo injected in the Target Knee Joint of Patients with grade 2 to 4 osteoarthritis on the Kellgren and Lawrence severity index.
Protocol code: 4MB-LAS-P
Sponsor: 4moving Biotech (Pharmaceutical company). Phase: Human Pharmacology (Phase I)- Other. Countries: Belgium (ended).
Therapeutic area(s): Diseases [C] - Musculoskeletal Diseases [C05]
Gender: Female, Male. Age: 18-64 years, 65+ years. Enrolment: 32.
Status: Ended. Start date (EU): 2023-05-10. End date (EU): 2023-10-31. Decision date: 2022-06-23. Results received: Yes. Last updated: 2023-09-21.

Condition(s): Knee osteoarthritis
Product: MINI-PLASCO NACL B. BRAUN 0,9 %, solution injectable, Victoza 6 mg/ml solution for injection in pre-filled pen, MINI-PLASCO NACL B. BRAUN 0,9 %, solution injectable

Primary endpoint: Number of Adverse events (AEs), serious AEs (SAEs) (Common Terminology Criteria Adverse Events [CTC-AE]) from ICF signature to D29, including target knee pain and tenderness, erythema, swelling, local pain at injection site., Vital signs from D-7 to D8, ECG from D-7 to D1: Mean change, number of Potentially Clinically Significant Abnormality (PCSA), Percentage of participants with PCSA., Laboratory changes (Red Blood Cells (RBC), White Blood Cells (WBC), Hemoglobin (Hb), platelets, alanine transaminase (ALT), aspartate transaminase (AST), glycemia, amylasemia, creatinin clearance) from D-7 to D8: Mean changes number of PCSA, Percentage of participants with PCSA.
Endpoint(s): Plasma concentration of liraglutide following a single IA injection. PK samples: D1 preinjection (T0-15min) and 2, 4, 8, 12, 16 and 24 hours post injection. Plasma concentrations will be performed by C.RIS Pharma (Saint Malo, France).

Source: https://euclinicaltrials.eu/ctis-public/view/2022-500271-31-00